EU clinical trial 2023-506601-19-00: Evaluation of the benefits of Administering immunosuppressive drugs as Single daily doses over the first Year after liver transplantation
Protocol code: 87RI23_0031
Sponsor: Centre Hospitalier Universitaire De Limoges (Hospital/Clinic/Other health care facility). Phase: Therapeutic use (Phase IV). Countries: France (ongoing, recruiting).
Therapeutic area(s): Analytical, Diagnostic and Therapeutic Techniques and Equipment [E] - Therapeutics [E02]
Gender: Female, Male. Age: 18-64 years, 65+ years. Enrolment: 200.
Status: Ongoing, recruiting. Start date (EU): 2025-04-15. Decision date: 2024-05-30. Results received: No. Last updated: 2026-04-09.

Condition(s): transplantation
Product: Advagraf 3 mg prolonged-release hard capsules, Advagraf 0.5 mg prolonged-release hard capsules, CellCept 500 mg film-coated tablets, CellCept 250 mg capsules, Advagraf 3 mg prolonged-release hard capsules, Advagraf 1 mg prolonged-release hard capsules, Advagraf 5 mg prolonged-release hard capsules, Advagraf 1 mg prolonged-release hard capsules, CellCept 250 mg capsules, CellCept 500 mg film-coated tablets, Advagraf 5 mg prolonged-release hard capsules, CellCept 250 mg capsules, Advagraf 5 mg prolonged-release hard capsules, Envarsus 1 mg prolonged-release tablets, Envarsus 1 mg prolonged-release tablets, Envarsus 0.75 mg prolonged-release tablets, Envarsus 0.75 mg prolonged-release tablets, Advagraf 1 mg prolonged-release hard capsules, Envarsus 4 mg prolonged-release tablets, Advagraf 1 mg prolonged-release hard capsules, Envarsus 4 mg prolonged-release tablets, Envarsus 0.75 mg prolonged-release tablets, Advagraf 3 mg prolonged-release hard capsules, Envarsus 4 mg prolonged-release tablets, Advagraf 0.5 mg prolonged-release hard capsules, Advagraf 0.5 mg prolonged-release hard capsules, Envarsus 1 mg prolonged-release tablets

Primary endpoint: The primary outcome will be a composite endpoint, named “treatment failure”, defined by the occurrence of any of the following events during the first 6 months (2nd objective) or during the first 18 months (1st objective) after transplantation: • Patient death, • Graft loss, • Biopsy-proven acute rejection, with a rejection activity index score ≥4 according to the Banff criteria
Endpoint(s): Comparison, between patients on XR-tacrolimus and patients on LCP-tacrolimus, at M18 post-transplantation a. The proportion of deaths b. The proportion of graft losses c. The proportion of biopsy-proven acute rejection with an activity score ≥4, Comparison, between patients the four arms, at M6 andM18 post-transplantation, of: a. The proportion of deaths b. The proportion of graft losses c. The proportion of biopsy-proven acute rejection with an activity score ≥4, Comparison, between patients on XR-tacrolimus and patients on LCP-tacrolimus, at M18 post-transplantation, of: a. The proportion of non-adherent patients b. Mean PCS-QOL and MCS-QOL, Comparison, between patients on XR-tacrolimus and patients on LCP-tacrolimus, at M18 post-transplantation, of the incidence of adverse events of interest, Comparison, between patients on MMF BID and patients on MMF QD , at M18 post-transplantation, of: a. The proportion of non-adherent patients b. Mean PCS-QOL and MCS-QOL c. The incidence of adverse events of interest, Comparison, between the four arms and at each post-transplantation period, of: a. Mean tacrolimus and MPA AUC0-24h, b. Mean tacrolimus C0/dose and AUC0-24h/dose, c. Mean MPA AUC0-24h/dose.

Source: https://euclinicaltrials.eu/ctis-public/view/2023-506601-19-00